EU clinical trial 2024-516986-35-00: A Phase 2 Study of Avutometinib (VS-6766, a Dual RAF/MEK Inhibitor) Alone and In Combination with Defactinib (FAK Inhibitor) in Recurrent Low-Grade Serous Ovarian Cancer (LGSOC) (RAMP 201)
Protocol code: VS-6766-201
Sponsor: Verastem Inc. (Pharmaceutical company). Phase: Therapeutic exploratory (Phase II). Countries: Belgium (ended), Spain (ended), France (ongoing, recruitment ended), Italy (ended).
Therapeutic area(s): Diseases [C] - Neoplasms [C04]
Gender: Female. Age: 18-64 years, 65+ years. Enrolment: 75.
Start date (EU): 2021-09-06. Decision date: 2024-09-30. Results received: No. Last updated: 2026-03-16.
Decision dates by country: ES: 2024-09-30, IT: 2024-10-14, FR: 2024-10-15, BE: 2024-10-01

Condition(s): Recurrent Low-Grade Serous Ovarian Cancer (LGSOC)
Product: VS-6766, VS-6063

Primary endpoint: Part A: Confirmed overall response rate (ORR; partial response [PR] + complete response [CR] defined according to Response Evaluation Criteria in Solid Tumors version 1.1 [RECIST 1.1]) as assessed by the blinded independent radiology review committee (BIRC) Part B: Confirmed ORR defined according to RECIST 1.1 as assessed by the BIRC Part C: Confirmed ORR defined according to RECIST 1.1 as assessed by the BIRC Part D: Confirmed ORR defined according to RECIST 1.1 as assessed by the BIRC
Endpoint(s): Part A, B, C and D: 1) Adverse events (AEs), serious AEs (SAEs), physical examinations, clinical laboratory values and tolerability (dose interruptions/reductions), 2) - Duration of response (DOR) - ORR as assessed by the Investigator - Progression free survival (PFS), defined as the time from first dose of study intervention to the first documentation of progressive disease (PD), or death from any cause - Disease control rate (DCR), defined as CR+PR+ stable disease (SD) - Overall survival (OS), 3) PK parameters derived from plasma concentrations of avutometinib, defactinib, and relevant metabolites

Source: https://euclinicaltrials.eu/ctis-public/view/2024-516986-35-00